EU clinical trial 2024-517140-65-00: A Phase 1/2, Open-Label, Platform Study to Evaluate Safety and Efficacy of the BCL-2 Inhibitor Surzetoclax (ABBV-453) given as Monotherapy or in Combination with Antimyeloma Regimens in Subjects with Multiple Myeloma
Protocol code: M25-275
Sponsor: AbbVie Deutschland GmbH & Co. KG (Pharmaceutical company). Phase: Phase I and Phase II (Integrated)- Other. Countries: Belgium (ongoing, recruiting), Portugal (authorised, recruiting), Sweden (ongoing, recruiting), Italy (authorised, recruiting), France (ongoing, recruiting), Poland (ongoing, recruiting), Germany (ongoing, recruiting).
Therapeutic area(s): Diseases [C] - Neoplasms [C04]
Gender: Female, Male. Age: 18-64 years, 65+ years. Enrolment: 76.
Start date (EU): 2025-10-23. Decision date: 2025-10-06. Results received: No. Last updated: 2026-06-26.
Decision dates by country: FR: 2025-10-07, IT: 2025-10-06, DE: 2025-10-08, SE: 2025-10-06, PL: 2025-10-10, PT: 2025-10-06, BE: 2025-10-06

Condition(s): Multiple Myeloma (MM).
Product: Surzetoclax, DEXAMETHASONE, DEXAMETHASONE, DARATUMUMAB, POMALIDOMIDE, POMALIDOMIDE, POMALIDOMIDE, Surzetoclax, DEXAMETHASONE

Primary endpoint: Dose Limiting Toxicities (DLT)s of surzetoclax, Safety and tolerability (AEs and SAEs, clinical laboratory parameters, vital sign measurements, and ECG results).
Endpoint(s): Overall Response Rate (ORR), Progression-Free Survival (PFS), Duration of Response (DOR), Time-to-Progression (TTP), Time to Next Treatment, Rate of minimal residual disease (MRD) Negativity Determined Centrally, , using Adaptive's clonoSEQ Next Generation Sequencing (NGS) assay, Overall survival (OS)

Source: https://euclinicaltrials.eu/ctis-public/view/2024-517140-65-00